EU clinical trial 2025-522452-16-00: A Phase 2, randomized, double-blind, placebo-controlled trial to investigate the efficacy and safety of 2 doses of vipoglanstat in patients with moderate to severe endometriosis-related pain – the NOVA trial
Protocol code: GS-248-203
Sponsor: Gesynta Pharma AB (Pharmaceutical company). Phase: Therapeutic exploratory (Phase II). Countries: Italy (authorised, recruitment pending), Hungary (ongoing, recruiting), Poland (ongoing, recruiting), Czechia (ongoing, recruiting), Bulgaria (ongoing, recruiting), Romania (ongoing, recruiting).
Therapeutic area(s): Diseases [C] - Female Urogenital Diseases and Pregnancy Complications [C13]
Gender: Female. Age: 18-64 years. Enrolment: 353.
Start date (EU): 2025-12-05. Decision date: 2025-11-21. Results received: No. Last updated: 2026-06-10.
Decision dates by country: BG: 2025-11-25, HU: 2025-11-24, CZ: 2025-11-24, RO: 2026-03-16, IT: 2025-11-21, PL: 2025-11-24

Condition(s): Endometriosis related pain
Product: Vipoglanstat, The placebo formulation for GS-248 is formulated in a capsule without the active ingredient. Both vipoglanstat capsules and placebo are identical capsules.

Primary endpoint: 1. Proportion of participants with at least 2.0 points, or at least 30%, reduction of mean worst NMPP NRS score, without increase in opioid rescue medication use, during non-menstrual days, from baseline to the fourth month of treatment.
Endpoint(s): 1. Change in mean worst NMPP NRS score from baseline to the fourth month of treatment, 2. Proportion of participants with at least 2.0 points, or at least 30%, reduction of mean worst DYS NRS score, without increase in rescue medication use, during menstrual bleeding days, from baseline to the fourth month of treatment., 3. Change in mean worst DYS NRS score from baseline to the fourth month of treatment, 4. Change in EHP-30 score from Visit 3 to Visit 7., 5. Change in EHP-30 sexual intercourse subscale score from Visit 3 to Visit 7., 6. Change in mean daily opioid rescue medication use for NMPP from baseline to the fourth month of treatment., 7. Change in mean daily opioid rescue medication use for DYS from baseline to the fourth month of treatment., 8. AEs., 9. Safety laboratory variables (clinical chemistry, hematology, and urinalysis).

Source: https://euclinicaltrials.eu/ctis-public/view/2025-522452-16-00